EU clinical trial 2023-509207-33-01: Phase 1b/2a clinical trial in early acute Spinal Cord Injury (SCI): A Single Blinded, Randomized, Proof-of-Concept study to determine the safety, tolerability and efficacy of TZ-161
Protocol code: TZ-161-101
Sponsor: Technophage Investigacao E Desenvolvimento Em Biotecnologia S.A. (Pharmaceutical company). Phase: Phase I and Phase II (Integrated)- Other. Countries: Portugal (suspended), Spain (authorised, recruiting).
Therapeutic area(s): Diseases [C] - Nervous System Diseases [C10]
Gender: Female, Male. Age: 18-64 years, 65+ years. Enrolment: 42.
Start date (EU): 2025-07-09. Decision date: 2024-06-03. Results received: No. Last updated: 2026-05-04.
Decision dates by country: ES: 2025-02-13, PT: 2024-06-03

Condition(s): Early acute spinal cord injury
Product: Relert 40 mg comprimidos revestidos por película

Primary endpoint: Incidence of treatment-emergent AEs and treatment-emergent SAEs between D1 and M6 in IMP plus SOC compared to SOC alone.
Endpoint(s): Absolute change in MAS and BPI from baseline to follow-up visits (M1, M3 and M6) in IMP plus SOC compared to SOC alone., Difference in length of stay observed in IMP plus SOC compared to SOC alone regarding: a. Time spent in the ICU [defined as time from ICU admission to discharge from ICU]. b. Time spent in the hospital [defined as time from hospital admission to discharge from hospital]., Absolute change in ASIA Impairment Scale (AIS) – ISNCSCI standards – motor and sensory scores from baseline to follow-up visits (M1, M3 and M6) in IMP plus SOC compared to SOC alone.

Source: https://euclinicaltrials.eu/ctis-public/view/2023-509207-33-01